EU clinical trial 2022-500408-22-00: OptIMMize-2: A Phase 3 Multicenter, Single-arm, Open-label Extension Study to Assess the Safety, Tolerability, and Efficacy of Risankizumab in Subjects With Moderate to Severe Plaque Psoriasis Who Have Completed Participation in Study M19-977 (OptIMMize-1).
Protocol code: M19-973
Sponsor: Abbvie Deutschland GmbH & Co. KG (Pharmaceutical company). Phase: Therapeutic confirmatory (Phase III). Countries: Germany (ongoing, recruiting), Spain (ongoing, recruiting), Poland (ongoing, recruiting).
Therapeutic area(s): Diseases [C] - Immune System Diseases [C20]
Gender: Female, Male. Age: 0-17 years. Enrolment: 70.
Status: Ongoing, recruiting. Start date (EU): 2022-09-14. Decision date: 2022-07-19. Results received: No. Last updated: 2026-08-06.
Decision dates by country: DE: 2022-07-19, ES: 2022-07-19, PL: 2022-07-19

Condition(s): Plaque Psoriasis
Product: Risankizumab, ABBV-066

Primary endpoint: Number of Participants With Adverse Events

Source: https://euclinicaltrials.eu/ctis-public/view/2022-500408-22-00